EU clinical trial 2025-520805-10-00: A Phase 3, Randomized, Double-Blinded, Placebo-Controlled Study Evaluating the Efficacy and Safety of Empasiprubart IV in Adults With Chronic Inflammatory Demyelinating Polyneuropathy
Protocol code: ARGX-117-2402
Sponsor: Argenx (Pharmaceutical company). Phase: Therapeutic confirmatory (Phase III). Countries: Czechia (authorised, recruiting), Denmark (authorised, recruiting), Poland (ongoing, recruiting), Slovenia (authorised, recruiting), Netherlands (authorised, recruiting), Austria (authorised, recruiting), Estonia (ongoing, recruiting), Slovakia (authorised, recruiting), Hungary (authorised, recruiting), Finland (authorised, recruitment pending), Bulgaria (ongoing, recruiting), France (ongoing, recruiting), Italy (authorised, recruiting), Greece (authorised, recruiting), Romania (ongoing, recruiting).
Therapeutic area(s): Diseases [C] - Nervous System Diseases [C10]
Gender: Female, Male. Age: 18-64 years, 65+ years. Enrolment: 86.
Start date (EU): 2026-03-12. Decision date: 2026-02-10. Results received: No. Last updated: 2026-06-15.
Decision dates by country: NL: 2026-02-11, SK: 2026-02-10, DK: 2026-02-10, CZ: 2026-02-10, FR: 2026-02-16, IT: 2026-02-12, SI: 2026-02-11, AT: 2026-02-16, BG: 2026-02-16, EE: 2026-02-13, FI: 2026-02-10, HU: 2026-02-16, PL: 2026-02-16, GR: 2026-02-12, RO: 2026-02-13

Condition(s): Chronic inflammatory demyelinating polyneuropathy (CIDP)
Product: ARGX-117, Placebo for empasiprubart- solution for IV infusion

Primary endpoint: Reduction of ≥1 point compared with baseline in aINCAT score at week 24
Endpoint(s): Change from baseline in I-RODS centile points score - up to 24 weeks (part A), Change from baseline in MRC-SS at week 24, Change from baseline in grip strength (3-day moving average) in the dominant hand at week 24, Time to reduction of ≥1 point from baseline in aINCAT score - up to 24 weeks, Time to increase of ≥1 point compared with baseline in aINCAT score up to week 24, Change from baseline in grip strength (3-day moving average) of both hands over time and change from baseline in grip strength (daily average) for both hands, Change from baseline in MRC-SS over time. Up to 96 weeks (Part B), Change from baseline in aINCAT score over time, Change from baseline in EQ-5D-5L over time, Change from baseline in RT-FSS over time, Change from baseline in BPI-SF over time, PGI-S values over time, PGI-C values over time, Incidence and prevalence of ADA against empasiprubart in serum, Incidence and prevalence of NAb against empasiprubart in serum, Incidence and severity of AEs, Incidence of SAEs, Clinically meaningful changes in laboratory parameters, ECG results, and vital signs, Absolute values and percentage change from baseline in free C2 and total C2 over time, Serum concentrations of empasiprubart over time, Reduction of ≥1 point in aINCAT over time, Increase of ≥1 point from baseline in aINCAT over time, Change from baseline in TUG at week 24

Source: https://euclinicaltrials.eu/ctis-public/view/2025-520805-10-00